EU clinical trial 2023-504554-35-00: Surgical treatment of large incisional hernia with botulinum toxin A injection: a double-blind randomized controlled trial
Protocol code: APHP220805
Sponsor: Assistance Publique Hopitaux De Paris (Hospital/Clinic/Other health care facility). Phase: Therapeutic confirmatory (Phase III). Countries: France (ongoing, recruiting).
Therapeutic area(s): Diseases [C] - Digestive System Diseases [C06]
Gender: Female, Male. Age: 18-64 years, 65+ years. Enrolment: 260.
Status: Ongoing, recruiting. Start date (EU): 2025-01-17. Decision date: 2024-04-29. Results received: No. Last updated: 2025-11-13.

Condition(s): incisional hernia
Product: Placebo of XEOMIN 100UY, powder for injection, XEOMIN 100 unités, poudre pour solution injectable

Primary endpoint: Occurrence of Clavien-Dindo classification grade II or higher post-operative complication during the 90-day postoperative period.
Endpoint(s): Length of hospital stay in days, Severity of complication according to the Clavien-Dindo classification during the 90-day postoperative period, Occurrence of CST during IH repair, Occurrence of incomplete wall closure (bridge closure) during IH repair, Sum of the length variation of the left and right lateral muscles (cm), sum of the width variation of the left and right lateral muscles (cm), sum of the width (cm) and surface (cm²) variation of the muscular defect; peritoneal sac volume (cm3) variation, between the pre-inclusion CT and the CT 4 weeks after BTA injection, Intravesical pressure, measured daily until bladder catheter removal, Pain on Analogical Visual Scale at inclusion, from 1st to 7th postoperative day and at 1, 3 (90 days), 6, and 12 months after surgery ; 90-day postoperative prescription of type 3 analgesics, Occurrence of post-operative abdominal wall disruption during a 90 days period after surgery; occurrence of clinical recurrence of the IH during the first year after surgery; occurrence of radiological recurrence of the IH at 12 months post-surgery; 1-year postoperative occurrence of clinical and radiological recurrence of the IH, or reoperation for recurrence;, EQ-5D-5L at inclusion, 90 days, 6, and 12 months after surgery

Source: https://euclinicaltrials.eu/ctis-public/view/2023-504554-35-00